EU clinical trial 2025-520998-39-00: A Phase 3 Randomized, Controlled Study to Assess the Efficacy and Safety of NVD003 compared with Iliac Crest Bone Graft in Pediatric Participants Treated Surgically for Congenital Pseudarthrosis of the Tibia
Protocol code: NVD003-CLN03
Sponsor: Novadip Biosciences (Pharmaceutical company). Phase: Therapeutic confirmatory (Phase III). Countries: France (ongoing, recruiting), Spain (authorised, recruitment pending), Belgium (ongoing, recruiting).
Therapeutic area(s): Diseases [C] - Congenital, Hereditary, and Neonatal Diseases and Abnormalities [C16]; Diseases [C] - Musculoskeletal Diseases [C05]
Gender: Female, Male. Age: 0-17 years. Enrolment: 4.
Start date (EU): 2025-11-07. Decision date: 2025-09-08. Results received: No. Last updated: 2026-03-10.
Decision dates by country: ES: 2025-09-10, BE: 2025-11-07, FR: 2025-09-12

Condition(s): Congenital pseudarthrosis of the tibia
Product: NVD003

Primary endpoint: Overall healing at 12 months, defined as a binary (yes/no) outcome derived from the following 3 outcomes: • Radiographic healing, defined as a score ≥13 on the modified Radiological Union Scale for Tibia (mRUST) scale (range 1 to 16) assessed by independent central readers (ICRs), Clinical healing measured by the absence of pain with weight-bearing, based on clinician’s assessment., No use of secondary interventions to promote or accelerate bone healing All 3 criteria must be met for a “yes” on overall healing for this endpoint to be achieved.
Endpoint(s): The following endpoints will be evaluated at 12 months after surgery with NVD003: • Radiographic healing • Clinical healing • Non-use of secondary interventions to promote or accelerate bone healing., • Number and severity of AEs related to NVD003 • Number of serious adverse events (SAEs) related to NVD003 • Units of blood transfused perioperatively (from start of surgical procedure until hospital discharge) • Duration of GS (in hours) • Duration of hospitalization after GS (in days) • Recurrent fracture within 12 months after GS., • Radiological bone union status at 3, 6, and 12 months after GS, assessed centrally by ICRs using the total extended Lane and Sandhu scoring (eLSS) method • Functional walking outcome, assessed using the timed 10-meter walking test (when appropriate) post GS at 3, 6, and 12 months., • Mean change from Baseline to 6 and 12 months after GS in QoL: o Pediatric Outcomes Data Collection Instrument (PODCI) parent report for children 2 years of age and above.

Source: https://euclinicaltrials.eu/ctis-public/view/2025-520998-39-00